EU clinical trial 2023-505796-76-00: Phase 1b safety study of xevinapant, weekly cisplatin, and radiotherapy in participants with unresected LA SCCHN
Protocol code: MS202359_0025
Sponsor: Merck Healthcare KGaA (Pharmaceutical company). Phase: Human Pharmacology (Phase I)- Other. Countries: Belgium (ended), Spain (ended).
Therapeutic area(s): Diseases [C] - Neoplasms [C04]
Gender: Female, Male. Age: 18-64 years, 65+ years. Enrolment: 12.
Status: Ended. Start date (EU): 2024-01-18. End date (EU): 2024-08-20. End date: 2024-08-21. Decision date: 2023-11-27. Results received: No. Last updated: 2024-06-06.
Decision dates by country: ES: 2024-06-06, BE: 2023-11-27

Condition(s): Locally Advanced Squamous Cell Carcinoma of the Head and Neck

Source: https://euclinicaltrials.eu/ctis-public/view/2023-505796-76-00